EU clinical trial 2024-513324-42-00: AFLOAT - Assessment of flecainide to lower the patent formamen Ovale closure risk of Atrial arrhytmia or tachycardia
Protocol code: APHP201110
Sponsor: Assistance Publique Hopitaux De Paris (Hospital/Clinic/Other health care facility). Phase: Therapeutic confirmatory (Phase III). Countries: France (ongoing, recruitment ended).
Therapeutic area(s): Diseases [C] - Cardiovascular Diseases [C14]
Gender: Female, Male. Age: 18-64 years, 65+ years. Enrolment: 186.
Status: Ongoing, recruitment ended. Start date (EU): 2022-03-23. Decision date: 2024-05-23. Results received: No. Last updated: 2024-05-23.

Condition(s): Patent Foramen Ovale Closure Atrial Arrhytmia or Tachycardia
Product: FLECAINIDE

Primary endpoint: The primary endpoint of the study will be a blind evaluation of the percentage of patients with at least one episode of symptomatic or asymptomatic AA (≥30s) recorded on long-term monitoring with an insertable cardiac monitor (ICM) during the 3 months after PFO closure AA is defined as any episode of AF, atrial flutter or atrial tachycardia that lasts 30 seconds or more, in accordance with the 2012 consensus statement from the Heart Rhythm Society and others (1).
Endpoint(s): - Percentage of patients with at least one episode of symptomatic or asymptomatic AA (≥30s) recorded on long-term monitoring with ICM during the 3-6 months period after PFO closure, Percentage of patients with at least one episode of symptomatic or asymptomatic AA (≥6 min) recorded on long-term monitoring with ICM device during the 3 months after PFO closure, AA burden and its evolution over time, Percentage of patients with at least one episode of symptomatic palpitations during the 3 and 6 months after PFO closure, Percentage of patients with at least one episode of fatal or non-fatal stroke or Transient Ischemic Attack (TIA) during the 3 and 6 months after PFO closure, Percentage of patients with at least one episode of non-scheduled practitioner-consultation or hospitalization for any cardiovascular reason during the 3 and 6 months after PFO closure, All-cause mortality during the 3 and 6 months after PFO closure, Percentage of patients with at least one episode of symptomatic or asymptomatic AA (≥6 min) recorded on long-term monitoring with ICM device during the whole follow-up period until battery run out or ICM removal., Rate of Flecainide-related adverse events

Source: https://euclinicaltrials.eu/ctis-public/view/2024-513324-42-00